EU clinical trial 2024-510721-26-00: A Randomized, double-blind, placebo-controlled, three-way cross-over study to assess the pharmacodynamic effects of an authorised and a new compound on nerve excitability threshold tracking in healthy male subjects.
Protocol code: CHDR2371
Sponsor: Centre for Human Drug Research (Laboratory/Research/Testing facility). Phase: Human Pharmacology (Phase I)- Other. Countries: Netherlands (ended).
Therapeutic area(s): Diseases [C] - Nervous System Diseases [C10]
Gender: Male. Age: 18-64 years. Enrolment: 18.
Status: Ended. Start date (EU): 2024-05-17. End date (EU): 2024-10-14. Decision date: 2024-05-06. Results received: No. Last updated: 2024-09-18.

Condition(s): neuropathic pain

Source: https://euclinicaltrials.eu/ctis-public/view/2024-510721-26-00